EU clinical trial 2024-510615-29-00: A randomized controlled open-label multicenter study to assess the efficacy of TCZ in treatment of late/chronic active antibody-mediated rejection in kidney transplant recipients
Sponsor: Vaestra Goetalandsregionen (Hospital/Clinic/Other health care facility). Phase: Therapeutic confirmatory (Phase III). Countries: Sweden (ongoing, recruitment ended), Spain (ongoing, recruitment ended).
Therapeutic area(s): Phenomena and Processes [G] - Immune system processes [G12]
Gender: Female, Male. Age: 18-64 years, 65+ years. Enrolment: 50.
Status: Ongoing, recruitment ended. Start date (EU): 2021-05-24. Decision date: 2024-03-01. Results received: No. Last updated: 2025-12-03.
Decision dates by country: ES: 2024-11-04, SE: 2024-06-17

Condition(s): Chronic active antibody-mediated rejection in kidney transplant recipients
Product: RoActemra 162 mg solution for injection in pre-filled syringe.

Primary endpoint: The primary efficacy endpoint is mean rate of change in eGFR decline from baseline to 24 months after start of treatment and at 1 month, then every 3 months for 36 months, and evaluating the results as a continuous variable using Modification of Diet for Renal Disease (MDRD) 4-variable equation, as it has been shown to better predict kidney function in kidney transplant recipients especially at low level of kidney function. Testing will be performed directly by accredited chemistry laboratories
Endpoint(s): Change from baseline in mean composite iBox risk score at 12 and 24 months after start of treatment, Safety: incidence, nature and severity of adverse events (AE) and serious AE (SAE) during 24 months of treatment period, Evolution of DSA, as assessed by appearance of new DSA, and change in strength of both immunodominant (iDSA) and cumulative DSA (cDSA), measured as MFI, from baseline at 12, 24 and 36 months after start of treatment, Histologic changes from baseline in protocol biopsy at 12 and 24 months after start of treatment, Changes from baseline in proteinuria at 12, 24 and 36 months after start of treatment, as assessed by urine albumin/creatinine ratio (UACR), Changes from baseline in renal function at 12, 24 and 36 months after start of treatment, as assessed by mGFR using iohexol clearance, Changes from baseline in renal function at 12 and 36 months after start of treatment, as assessed by eGFR, Incidence of patient survival at 12, 24 and 36 months after start of treatment, Incidence of graft survival (overall and death-censored) at 12, 24 and 36 months after start of treatment, Incidence of acute rejection (overall and by biopsy‐proven/clinical diagnosis), its type and Banff-grade if biopsy-proven at 12, 24 and 36 months after start of treatment, Incidence and Banff-grade of new chronic active T-cell mediated rejection at 12, 24 and 36 months after start of treatment, Experienced transplant-specific well-being, symptom burden, perceived threat of the risk of graft rejection and adherence to immunosuppressive medications at baseline,12, 24 and 36 months after start of treatment, and possible changes from baseline at each time-point as well as in comparison with other transplant recipients not suffering, Sex-, occupation-, civil- and educational status-related differences in transplant-specific well-being, symptom burden, perceived threat of the risk of graft rejection and adherence to immunosuppressive medications at baseline, 12, 24 and 36 months as well as in comparison with other transplant recipients not suffering

Source: https://euclinicaltrials.eu/ctis-public/view/2024-510615-29-00